EU clinical trial 2024-515562-14-00: Optimization of the management of drepanocytosis patients treated with hydroxyurea: Interest of the pharmacological therapeutic follow-up
Sponsor: Les Hopitaux Universitaires De Strasbourg (Hospital/Clinic/Other health care facility). Phase: Therapeutic use (Phase IV). Countries: France (ended).
Therapeutic area(s): Analytical, Diagnostic and Therapeutic Techniques and Equipment [E] - Therapeutics [E02]
Gender: Female, Male. Age: 0-17 years, 18-64 years. Enrolment: 30.
Status: Ended. Start date (EU): 2024-07-19. End date (EU): 2025-10-27. Decision date: 2024-07-19. Results received: No. Last updated: 2024-07-19.

Condition(s): Drepanocytosis
Product: HYDREA 500 mg, gélule, Siklos 1 000 mg film-coated tablet., Siklos 100 mg film-coated tablet., Siklos 100 mg film-coated tablet., Siklos 100 mg film-coated tablet.

Primary endpoint: Proportion of subjects with a time to reach LMA of less than 9 months
Endpoint(s): Clinical parameters of efficacy in both arms: has. a. Number of vaso-occlusive seizures b. Number of complications related to sickle cell disease and/or hydroxyurea c. Number of hospitalizations d. Time elapsed before the need for transfusion e. Percentage of HbF, Biological parameters of toxicity in both arms: has. a. Complete blood count, reticulocytes, ferritin b. Renal function (glomerular filtration rate estimated by cystatin C, plasma creatinine and urea) c. Liver function (AST, ALT, total and conjugated bilirubin)., Non-compliance parameters: has. a. Mean blood cell volume (MCV) b. Percentage of HbF, Population pharmacokinetic parameters of the 2 arms: a. AUC b. Clearance and volume of distribution of the drug., Pharmacokinetic analysis: has. a. Pharmacokinetic modeling of the population and identification of parameters involved in the inter- and intra-individual variability of the pharmacokinetics of the HU and allowing to better predict the individual dosage adaptation from our population study: i. Renal function ii. Age iii. Weight iv. Body surface v. % HbF b.Correlation between the concentrations obtained at the different sampling times and the AUC

Source: https://euclinicaltrials.eu/ctis-public/view/2024-515562-14-00